EU clinical trial 2024-511348-25-00: A Study to Evaluate Imetelstat (GRN163L) in Transfusion-Dependent Subjects with IPSS Low or Intermediate-1 Risk Myelodysplastic Syndrome (MDS) that is Relapsed/Refractory to Erythropoiesis-Stimulating Agent (ESA) Treatment
Protocol code: 63935937MDS3001
Sponsor: Geron Corp. (Pharmaceutical company). Phase: Phase II and Phase III (Integrated). Countries: Germany (ongoing, recruitment ended), Italy (ongoing, recruitment ended), Czechia (ongoing, recruitment ended), France (ongoing, recruitment ended), Netherlands (ongoing, recruitment ended), Belgium (ongoing, recruitment ended), Spain (ongoing, recruitment ended), Poland (ongoing, recruitment ended).
Therapeutic area(s): Diseases [C] - Neoplasms [C04]
Gender: Female, Male. Age: 18-64 years, 65+ years. Enrolment: 164.
Status: Ongoing, recruitment ended. Start date (EU): 2015-12-11. Decision date: 2024-05-22. Results received: No. Last updated: 2026-05-26.
Decision dates by country: ES: 2024-05-22, BE: 2024-05-24, DE: 2024-05-23, NL: 2024-05-22, CZ: 2024-05-23, FR: 2024-05-28, PL: 2024-06-03, IT: 2024-05-29

Condition(s): Myelodysplastic syndromes (MDS)
Product: Placebo to Imetelstat, IMETELSTAT

Primary endpoint: The primary efficacy endpoint of this study is the rate of RBC TI lasting at least 8 weeks. The 8-week RBC TI rate is defined as the proportion of subjects without any RBC transfusion during any consecutive 8 weeks (56 days) starting from Study Day 1. Study Day 1 is defined as the day of the first dose for subjects enrolled in Part 1 and the day of randomization for subjects enrolled in Part 2.
Endpoint(s): Safety of imetelstat in subjects with MDS (eg, incidence, intensity, and type of adverse events, vital signs measurements, clinical laboratory values, ECGs changes, and deaths), 24-week RBC TI rate, defined as the proportion of subjects without any RBC transfusion during any consecutive 24 weeks (168 days) starting from Study Day 1, Time to the 8-week (24 week) RBC TI, defined as the interval from Study Day 1 to the first day of the first 8-week (24 week) RBC TI period, Duration of RBC TI, defined as the first day of the longest RBC TI period to the date of the first RBC transfusion after the TI period starts, Rate of hematologic improvement, including HI-E, per modified IWG 2006, Rates of CR, PR, or mCR per modified IWG 2006, OS, defined as the interval from Study Day 1 to death from any cause. Survival time of living subjects will be censored on the last date a subject is known to be alive or lost to follow-up, Progression free survival, defined as the time interval from Study Day 1 to the first date of disease progression or death from any cause, whichever occurs first. For subjects who do not have documented disease progression and who are still alive at the end of the study or clinical cutoff will be censored at the last disease evaluation date., Time to progression to AML, defined as the interval from Study Day 1 to the date of AML diagnosis. For subjects who have not progressed to AML and are still alive at the cutoff date for the analysis or who withdraw from the study (withdrawal of consent or lost to follow-up), data will be censored at the date of the last disease evaluation, Amount and relative change in RBC transfusions, Rate of myeloid growth factors usage, defined as the proportion of subjects receive any myeloid growth factors starting from Study Day 1; duration of myeloid growth factor administered starting from Study Day 1, Assessment of QUALMS, FACT-An, and EQ-5D-5L, Pharmacokinetic parameters (eg, Cmax, AUC0-t), and immunogenicity of imetelstat (eg, antibodies to imetelstat), Medical resource utilization data including hospitalization, emergency room visits, and hematology specialist visits, ECG parameters including change in QT interval by Fridericia's correction method (ΔQTcF) in the Ventricular Repolarization substudy (Part 2 only)

Source: https://euclinicaltrials.eu/ctis-public/view/2024-511348-25-00